EU clinical trial 2024-510802-10-00: The impact of pramlintide on top of semaglutide in obese people with prediabetes
Sponsor: Esbjerg Sygehus (Hospital/Clinic/Other health care facility). Phase: Phase II and Phase III (Integrated). Countries: Denmark (not authorised).
Therapeutic area(s): Diseases [C] - Nutritional and Metabolic Diseases [C18]
Gender: Female, Male. Age: 18-64 years, 65+ years. Enrolment: 40.
Status: Not authorised. Decision date: 2024-12-03. Results received: No. Last updated: 2024-12-03.

Condition(s): Obesity (BMI ≧ 30kg/m2), Pre-diabetes (HbA1c 39-47 mmol/mol)
Product: PARACETAMOL, SEMAGLUTIDE

Primary endpoint: Change in kilocalorie (kCal) consumption at ad libitum meal test, from baseline, to after 25 weeks, and after 26 weeks of semaglutide treatment, of which the last week is with the addition of pramlintide.
Endpoint(s): Total weight loss from baseline, after 25 weeks, and at the end of the study, both as kg and as % of total body weight, Difference in total weight loss between the phenotypes, Change in appetite and satiety sensations as measured by VAS prior to and following the meal tests performed at baseline, after 25 weeks, and at the end of the study, Change in gastric emptying rate assessed by paracetamol test performed at baseline, after 25 weeks, and at the end of the study

Source: https://euclinicaltrials.eu/ctis-public/view/2024-510802-10-00